EU clinical trial 2024-515708-38-01: Safety and Efficacy of Induced Pluripotent Stem Cell-derived Engineered Human Myocardium as Biological Ventricular Assist Tissue in Terminal Heart Failure
Protocol code: 02289
Sponsor: Universitaetsmedizin Goettingen (Hospital/Clinic/Other health care facility). Phase: Phase I and Phase II (Integrated)- First administration to humans. Countries: Germany (ongoing, recruiting).
Therapeutic area(s): Diseases [C] - Cardiovascular Diseases [C14]
Gender: Female, Male. Age: 18-64 years, 65+ years. Enrolment: 53.
Status: Ongoing, recruiting. Start date (EU): 2021-01-29. Decision date: 2024-08-16. Results received: No. Last updated: 2026-07-28.

Condition(s): Heart failure
Product: Engineered Human Myocardium (EHM)

Primary endpoint: Part A (Dose Escalation steps): Adverse events related to the procedure, including in particular arrhythmic events and worsening of disease progression within 28 days (based on a comparison of data obtained during visit 2 and visit 7), Part B: Adverse events related to the procedure, including in particular arrhythmic events and worsening of disease progression within the whole study duration, Structural endpoint: Change from baseline in EHM target heart wall thickness (TWTh) measured by echocardiography or cardiac CT or cardiac MRI over 12 months, Functional endpoint: Change from baseline in left/right ventricular ejection fraction (LV-EF/RV-EF) measured by echocardiography or cardiac CT or cardiac MRI in the LV/RV cohorts over 12 months, Patient reported outcome/quality of life: Change from baseline in Kansas City Cardiomyopathy Questionnaire- Overall Summary Score (KCCQ-OSS) over 12 months
Endpoint(s): Frequency of major adverse cardiac events (MACE; non-fatal myocardial infarction, non-fatal stroke and cardiovascular death), Frequency and severity of arrhythmic events, Incidence of immune rejection (DSA, [allograft DNA - exploratory]), Incidence of mechanical perturbation of ventricular function by EHM graft, Recurrent HF hospitalizations, Time to mechanical circulatory assist device implantation., Change in NYHA classification, Functional status in patients as determined by cardiopulmonary stress testing (VO2max) and six-minute walk test (6MWT) distance, Quality of life assessed by quality of life scores (KCCQ-23 and EQ-5D-5L), All-cause and cardiovascular mortality, Time to heart transplantation.

Source: https://euclinicaltrials.eu/ctis-public/view/2024-515708-38-01